EU clinical trial 2024-518242-24-00: Multicenter, randomized, double-blind, comparative clinical trial to assess the efficacy of Zinc Acexamate versus a placebo in improving the prognosis of patients with advanced chronic liver disease (cACLD).
Protocol code: IC/LV/ACZ/PCHC
Sponsor: Fundacio Hospital Universitari Vall D’Hebron Institut De Recerca (Laboratory/Research/Testing facility). Phase: Therapeutic confirmatory (Phase III). Countries: Spain (ongoing, recruitment ended).
Therapeutic area(s): Diseases [C] - Digestive System Diseases [C06]
Gender: Female, Male. Age: 18-64 years, 65+ years. Enrolment: 300.
Status: Ongoing, recruitment ended. Start date (EU): 2022-06-27. Decision date: 2024-10-18. Results received: No. Last updated: 2026-06-26.

Condition(s): Chronic liver disease
Product: COPINAL 300 mg cápsulas, Placebo has the same composition than imp except the active substance

Primary endpoint: Occurrence of time-dependent clinical events during study follow-up, along with the distribution of CSPH risk estimated by the ANTICIPATE model. Clinical events are defined as the sum of: 1. Hepatic decompensation defined as the presence of clinical ascites, gastrointestinal bleeding due to portal hypertension, and hepatic encephalopathy. 2. Hepatocellular carcinoma. 3. Death from liver causes (considering non-hepatic death as a competitive risk). 4. Liver transplant.

Source: https://euclinicaltrials.eu/ctis-public/view/2024-518242-24-00